EU clinical trial 2022-502910-10-00: A Global, Phase 1/2, Open-label, Dose Optimization Study to Evaluate the Safety, Pharmacodynamics, and Pharmacokinetics of mRNA-3927 in Participants with Propionic Acidemia
Protocol code: mRNA-3927-P101
Sponsor: Moderna Inc. (Pharmaceutical company). Phase: Phase I and Phase II (Integrated)- First administration to humans. Countries: France (ongoing, recruitment ended), Spain (ongoing, recruitment ended), Italy (ended), Netherlands (ongoing, recruitment ended).
Therapeutic area(s): Diseases [C] - Nutritional and Metabolic Diseases [C18]
Gender: Female, Male. Age: 0-17 years, 18-64 years. Enrolment: 32.
Start date (EU): 2026-06-23. Decision date: 2024-06-03. Results received: No. Last updated: 2026-07-06.
Decision dates by country: IT: 2024-06-05, ES: 2024-06-03, NL: 2024-06-10, FR: 2024-06-03

Condition(s): Propionic Acidemia
Product: FAMOTIDINE, SODIUM CHLORIDE, CETIRIZINE, IBUPROFEN, DEXAMETHASONE, mRNA-3927, PARACETAMOL

Primary endpoint: Part 1: Incidence and severity of AEs (including mRNA-3927-related and not related AEs), SAEs, and AEs leading to treatment discontinuation, Part 2: Change in annualized frequency of CEC-adjudicated MDEs during the 12-month Treatment Period with mRNA-3927 compared to the annualized frequency of CEC-adjudicated MDE during the Pretreatment Period, Part 3: Incidence and severity of TEAEs, SAEs, AESIs (eg, IRR and hypersensitivity), and TEAEs leading to treatment discontinuation
Endpoint(s): 1. Part 1: -Change in blood 2-MC and 3-HP levels from baseline (pretreatment levels) to postdose levels measured after single and repeated administrations of mRNA-3927 -Estimation of PD parameters from baseline after single and repeated administration of mRNA-3927, including Emax, AUEC, and duration of response, 2. Part 1: -Estimation of PK parameters of PCCA and PCCB mRNAs, including Cmax, tmax, AUC, t½, CL, Vz, and Vss -Measurement of SM-86 after single and repeated dosing -Presence and titers of ADA against anti-PEG and APA against anti-PCC, 3. Part 2 - Secondary: Efficacy Change in annualized frequency of CEC-adjudicated MDE-related hospitalizations during the 12-month Treatment Period with mRNA-3927 compared to the annualized frequency of CEC-adjudicated MDE-related hospitalizations during the Pretreatment Period, 3 Cont.: Change in annualized frequency of CEC-adjudicated PA-related hospitalizations during the 12-month Treatment Period with mRNA-3927 compared to the annualized frequency of CEC-adjudicated PA-related hospitalizations during the Pretreatment Perioda, 4. • Change in annualized frequency of CECadjudicated MDEs during the 12-month Treatment Period with mRNA-3927 compared to the annualized frequency of CEC-adjudicated MDEs during the Pretreatment Period by the following severity grades: Grade 1, Grade 2, Grade 3, 4 Cont.: Change from Baseline in PedsQLTM total score and Physical Function Score at Week 52 • Change from Baseline in MMAPAQ-PSS total score at Week 52, 5. Proportions of patients distributed into ‘mild’ ‘moderate’ and ‘severe’ categories based on IGA-S severity levels at Week 52Proportion of participants meeting ‘modestly improved’ or ‘much improved’ in IGA-I at Week 52, 5 Cont.: Change in annualized frequency of CECadjudicated PA-related urgent healthcare encounters during the 12-month Treatment Period with mRNA-3927 compared to the annualized frequency of PA-related urgent healthcare encounters during the Pretreatment Period Secondary: PD, 6. Change in blood biomarkers including 3-HP and 2-MC from baseline (pretreatment levels) to posttreatment levels measured afteradministrations of mRNA-3927 -Estimation of PD parameters of blood 3-HP and 2-MC after administration of mRNA-3927, including AUC_Below_B,AUC_Net_B, and Emax, 7. Part 2- Secondary: Safety -Incidence and severity of TEAEs, SAEs, AESIs (eg, IRR and hypersensitivity), and TEAEs leading to treatment discontinuation, 8. Part 3 - Key Secondary: - Annualized frequency of CEC-adjudicated MDEs during the 12 month Treatment Period., 8 Cont.: Annualized frequency of CEC-adjudicated MDE-related hospitalization during the 12 month Treatment Period - Annualized frequency of CEC-adjudicated PA-related hospitalization during the 12-month Treatment Period, 9. - Annualized frequency of CEC-adjudicated MDE during the 12 month Treatment Period by the following MDE severity grades: Grade 1, Grade 2, Grade 3 • Change from baseline in PCOAs: - PedsQL Physical Function score, 9 Cont.: MMAPAQ-PSS total score - PedsQL total score • Proportions of patients distributed into ‘mild’ ‘moderate’ and ‘severe’ categories based on IGA-S severity levels at Week 52. Proportion of participants meeting ‘modestly improved’ or ‘much improved’ in IGA-I., 10. Annualized frequency of CEC-adjudicated PA-related urgent healthcare encounters during the 12-month Treatment Period. Secondary: PD - Change in blood biomarkers including 3-HP and 2-MC from baseline (pretreatment levels) to postdose levels measured after single and repeated administrations of mRNA-3927, 10 Cont.: Estimation of PD parameters of blood 3-HP and 2-MC after administration of mRNA-3927, including AUC_Below_B, AUC_Net_B, and Emax., 11. Part 3 - Secondary: PK - Estimation of PK parameters of PCCA and PCCB mRNAs, including Cmax, tmax, AUC, t½, CL, Vz, and Vss Estimation of PK parameters of SM-86 and OL-56, including AUC, Cmax, tmax.

Source: https://euclinicaltrials.eu/ctis-public/view/2022-502910-10-00